EU clinical trial 2024-518125-15-00: Efficacy and safety of anakinra in non-COVID-19 related ARDS. ESKA study.
Protocol code: CARR-ARDS-2021
Sponsor: Azienda Sanitaria Universitaria Friuli Centrale (Hospital/Clinic/Other health care facility). Phase: Therapeutic exploratory (Phase II). Countries: Italy (authorised, recruitment pending).
Therapeutic area(s): Diseases [C] - Respiratory Tract Diseases [C08]
Gender: Female, Male. Age: 18-64 years, 65+ years. Enrolment: 36.
Status: Authorised, recruitment pending. Decision date: 2024-11-18. Results received: No. Last updated: 2026-04-14.

Condition(s): Acute respiratory distress syndrome (ARDS)
Product: Kineret 100 mg/0.67 ml solution for injection in pre-filled syringe.

Primary endpoint: The main aim of this study is to evaluate ventilation-free days.
Endpoint(s): - 28-day mortality; - ICU mortality; - In-hospital mortality; - Improved PaO2/FiO2 ratio (measurement at day 0 and day 28); - Driving pressure reduction (measurement at day 0 and day 28); - Reduction peak pressure (measurement at day 0 and day 28); - Reduction plateau pressure (measurement at day 0 and day 28); - Days free from multi-organ damage calculated by Sequential Organ Failure Assessment methodology (SOFA) score (SOFA score <2) at day 28

Source: https://euclinicaltrials.eu/ctis-public/view/2024-518125-15-00